EU clinical trial 2023-505704-30-00: A Phase 1b/2 Open-label Study to Evaluate Safety, Tolerability, Pharmacokinetics, and Exploratory Efficacy Following Fosigotifator Administration in Adult and Pediatric Subjects with Vanishing White Matter Disease
Protocol code: M23-523
Sponsor: Calico Life Sciences LLC (Pharmaceutical company). Phase: Phase I and Phase II (Integrated)- Other. Countries: Netherlands (ongoing, recruiting).
Therapeutic area(s): Diseases [C] - Nervous System Diseases [C10]
Gender: Female, Male. Age: 0-17 years, 18-64 years, 65+ years. Enrolment: 16.
Status: Ongoing, recruiting. Start date (EU): 2024-03-22. Decision date: 2024-02-19. Results received: No. Last updated: 2026-04-16.
Decision dates by country: NL: 2024-04-25

Condition(s): Vanishing White Matter disease
Product: ABBV-CLS-7262, ABBV-CLS-7262

Primary endpoint: AEs and SAEs during the Safety Evaluation Period, Vital signs, ECGs, clinical laboratory tests, and suicidality assessments during the Safety Evaluation Period, Plasma concentrations of A-1684909 at pre-specified visits from Baseline up to Week 96 for all cohorts, CSF concentrations of A-1684909 at Week 12, Week 48, and Week 96 for all cohorts, Plasma PK parameters of A-1684909 following dosing at V4 (Study Day 14) for Cohorts 1 and 1b: Cmax; Tmax; AUC0-24h; Ctrough; and t1/2, functional
Endpoint(s): AEs and SAEs at last visit (Week 197), Vital signs, ECGs, clinical laboratory tests and suicudality up to last vist (Week 197)

Source: https://euclinicaltrials.eu/ctis-public/view/2023-505704-30-00